EU clinical trial 2022-500868-36-00: Study of REGN6569 and Cemiplimab in Adult Patients with Advanced Solid Tumor Malignancies
Protocol code: R6569-ONC-1933
Sponsor: Regeneron Pharmaceuticals Inc. (Pharmaceutical company). Phase: Human Pharmacology (Phase I)- First administration to humans. Countries: Spain (ended).
Therapeutic area(s): Diseases [C] - Neoplasms [C04]
Gender: Female, Male. Age: 18-64 years, 65+ years. Enrolment: 19.
Status: Ended. Start date (EU): 2021-08-11. End date (EU): 2025-02-07. End date: 2025-02-08. Decision date: 2024-09-03. Results received: No. Last updated: 2024-09-03.

Condition(s): Squamous Cell Carcinoma of Head and Neck

Source: https://euclinicaltrials.eu/ctis-public/view/2022-500868-36-00